EU clinical trial 2024-515545-41-00: Measuring of the duration of action of different doses of rocuronium-induced neuromuscular block in infants during surgical treatment of craniosynostosis - a prospective, case-controlled study
Protocol code: AITT 2023/8
Sponsor: University Of Debrecen (Educational Institution). Phase: Therapeutic use (Phase IV). Countries: Hungary (authorised, recruiting).
Therapeutic area(s): Analytical, Diagnostic and Therapeutic Techniques and Equipment [E] - Diagnosis [E01]; Not possible to specify
Gender: Female, Male. Age: 0-17 years. Enrolment: 20.
Status: Authorised, recruiting. Start date (EU): 2024-09-05. Decision date: 2024-09-03. Results received: No. Last updated: 2024-09-03.

Condition(s): a prospective, case-controlled study
Product: Rocuronium bromide hameln 10 mg/ml oldatos injekció/infúzió

Primary endpoint: The primary endpoint of both the first and second phase of the study is to investigate the extent to which sevoflurane used to maintain inhalational anaesthesia and propofol used to maintain total intravenous anaesthesia potentiate the pharmacokinetic properties of rocuronium at different doses. The translational clinical utility of this may be that knowledge in this age population will contribute to the safe implementation of reversal of muscle relaxant action.

Source: https://euclinicaltrials.eu/ctis-public/view/2024-515545-41-00